EU clinical trial 2024-518197-14-00: Lung Microbiota’s evolution after use of Nitrous Oxide on pediatric patient needing airway samples - MicroNO
Protocol code: 29BRC23.0238
Sponsor: Centre Hospitalier Regional Et Universitaire De Brest (Hospital/Clinic/Other health care facility). Phase: Therapeutic exploratory (Phase II). Countries: France (ended).
Therapeutic area(s): Diseases [C] - Respiratory Tract Diseases [C08]
Gender: Female, Male. Age: 0-17 years. Enrolment: 40.
Status: Ended. Start date (EU): 2025-09-24. End date (EU): 2026-03-23. Decision date: 2025-02-12. Results received: No. Last updated: 2025-08-26.
Decision dates by country: FR: 2025-04-24

Condition(s): Pediatric respiratory disorder
Product: KALINOX 50%/50%, gaz medicinal comprimé

Primary endpoint: Pulmonary bacterial biodiversity assessed using quantitative indices such as alpha diversity and beta diversity calculated for good-quality respiratory samples
Endpoint(s): Assessment of sputum tolerance induced by -The use of age-appropriate anxiety scores (mYPAS-SF, cf. appendix 2) -Likert scales to assess the MKDE practitioner's feelings (cf. Appendix 3) -A numerical scale from 0 to 10 to assess the parents' feelings, Quality of samples according to cytological score, Collection of adverse events, Difference between ECBC with and without MEOPA (direct examination, count and culture), Catalog of bacterial taxa identified by 16S v3-v4 targeted metagenomics.

Source: https://euclinicaltrials.eu/ctis-public/view/2024-518197-14-00